EU clinical trial 2024-515410-41-00: A PHASE I/II, OPEN-LABEL, DOSE ESCALATION AND EXTENSION STUDY OF INTRAVESICAL ECISKAFUSP ALFA IN COMBINATION WITH BACILLUS CALMETTE-GUÉRIN (BCG) IN PARTICIPANTS WITH BCG-UNRESPONSIVE HIGH- RISK NON-MUSCLE INVASIVE BLADDER CANCER (NMIBC)
Protocol code: BP45381
Sponsor: F. Hoffmann-La Roche AG (Pharmaceutical company). Phase: Phase I and Phase II (Integrated)- Other. Countries: Italy (ended), France (ended), Netherlands (ended), Poland (ended), Denmark (ended), Spain (ended), Germany (ended).
Therapeutic area(s): Diseases [C] - Neoplasms [C04]
Gender: Female, Male. Age: 18-64 years, 65+ years. Enrolment: 17.
Status: Ended. Start date (EU): 2025-04-01. End date (EU): 2025-05-16. End date: 2025-05-17. Decision date: 2025-03-17. Results received: No. Last updated: 2025-05-07.
Decision dates by country: DK: 2025-03-17, DE: 2025-03-18, IT: 2025-03-19, ES: 2025-03-18, NL: 2025-03-17, PL: 2025-03-24, FR: 2025-03-18

Condition(s): BCG-Unresponsive High-Risk Non-Muscle Invasive Bladder Cancer (NMIBC)
Product: BCG-MEDAC, poudre et solvant pour suspension intravésicale, PD1IL2v iMAb

Primary endpoint: Phase I: Incidence, nature, and severity of adverse events (AEs) graded according to the National Cancer Institute (NCI) Common Terminology Criteria for Adverse Events (CTCAE), Phase I: Nature and frequency of dose-limiting toxicities (DLTs), Phase I: RDE to be selected based on evaluation of safety, Phase II (Cohort A): Complete response (CR) rate at 12 months
Endpoint(s): Phase I, and Phase II (Cohorts A and B): CR rate at any time, Phase I, and Phase II (Cohorts A and B): CR rate at 6, 18, and 24 months, For Phase I, and Cohort B in Phase II: CR rate at 12 months, Phase I, and Phase II (Cohorts A and B): Duration of response (DoR), Phase I, and Phase II (Cohorts A and B): DoR rate at specific time points (at 6, 12, 18, 24, 30, and 36 months)., Phase I, and Phase II (Cohorts A and B): Time to worsening of grade or stage, or death., Phase I, and Phase II (Cohorts A and B): Progression free survival (PFS) to muscle invasive or metastatic disease or death., Phase I, and Phase II (Cohorts A and B): Time to cystectomy., Phase II (Cohorts A and B): Incidence, nature, and severity of adverse events (AEs) graded according to the National Cancer Institute (NCI) Common Terminology Criteria for Adverse Events (CTCAE), Phase II (Cohorts A and B): Incidence and titer of eciskafusp alfa anti-drug antibodies (ADAs) during the study relative to prevalence of ADAs at baseline (serum)., Phase II: Pre-treatment and on-treatment (as available) PD-L1 expression in the TME., Phase II: Pre-treatment CD8+ T cell prevalence., Phase II: Baseline urine tumor DNA, Phase II: On treatment vs. baseline urine tumor DNA.

Source: https://euclinicaltrials.eu/ctis-public/view/2024-515410-41-00